EU clinical trial 2022-502716-37-00: A PHASE 2 STUDY EVALUATING INCB099280 IN PARTICIPANTS WITH SELECT SOLID TUMORS WHO ARE IMMUNE CHECKPOINT INHIBITOR–NAÏVE
Protocol code: INCB 99280-211
Sponsor: Incyte Corp. (Pharmaceutical company). Phase: Therapeutic exploratory (Phase II). Countries: Romania (ended), Hungary (ended), Greece (ended).
Therapeutic area(s): Diseases [C] - Neoplasms [C04]
Gender: Female, Male. Age: 18-64 years, 65+ years. Enrolment: 70.
Status: Ended. Start date (EU): 2023-11-27. End date (EU): 2026-02-04. End date: 2026-07-27. Decision date: 2023-09-05. Results received: No. Last updated: 2024-10-11.
Decision dates by country: HU: 2023-09-08, RO: 2023-09-11, GR: 2023-09-05

Condition(s): Recurrent or advanced/metastatic solid tumors who are immunotherapy naive and may or may not have been treated with prior therapy for their disease.
Product: INCB099280

Primary endpoint: Objective response, defined as having a best overall response of confirmed CR or PR by investigator assessment per RECIST v1.1., Incidence of TEAEs, assessed by physical examinations, changes in vital signs and ECGs, and analysis of clinical laboratory samples., Incidence of TEAEs leading to dose interruption, dose reduction, or study drug discontinuation.
Endpoint(s): Disease control, defined as having a best overall response of confirmed CR or PR, or SD, after a minimum of 15 weeks following the initiation of study treatment by investigator assessment per RECIST v1.1., DOR, defined as the time from the earliest date of confirmed CR or PR to the earliest date of disease progression by investigator assessment per RECIST v1.1 or death due to any cause if occurring sooner than progression., TTR, defined as the time from the date of first dose to the earliest date of confirmed CR or PR by BICR per RECIST v1.1 or composite criteria for metastatic cSCC and WHO criteria for locally advanced cSCC., PFS, defined as the time from the date of first dose to the earliest date of disease progression by BICR per RECIST v1.1 or composite criteria for metastatic cSCC and WHO criteria for locally advanced cSCC or death due to any cause if occurring sooner than progression., OS, defined as the time from the date of first dose to death due to any cause., INCB099280 concentration in plasma.

Source: https://euclinicaltrials.eu/ctis-public/view/2022-502716-37-00